EU clinical trial 2024-511807-41-01: TIC-TAC-SAM « Comparison of two strategies of etoposide initiation in severe sporadic hemophagocytic lymphohistiocytosis in intensive care: a randomized trial »
Protocol code: APHP230874
Sponsor: Assistance Publique Hopitaux De Paris (Hospital/Clinic/Other health care facility). Phase: Therapeutic confirmatory (Phase III). Countries: France (authorised, recruitment pending).
Therapeutic area(s): Diseases [C] - Pathological Conditions, Signs and Symptoms [C23]
Gender: Female, Male. Age: 18-64 years, 65+ years. Enrolment: 176.
Status: Authorised, recruitment pending. Decision date: 2026-02-27. Results received: No. Last updated: 2026-07-17.

Condition(s): Hemophagocytic lymphohistiocytosis (HLH)
Product: DEXAMETHASONE, ETOPOSIDE

Primary endpoint: The occurrence of an event defined as the onset or worsening of organ failures, evaluated using the modified Sequential Organ Failure Assessment (SOFA) score (excluding the hematologic component). An event will be defined as an increase of at least 1 point for at least two organ systems compared to Day 0. In the delayed arm, the use of rescue etoposide treatment or in case of secondary aggravation during follow-up will also be considered an event.
Endpoint(s): Time to death after inclusion (with a maximum follow-up duration of 60 days), Number of ventilator-free days between inclusion and Day 14, Number of catecholamine-free days between inclusion and Day 14, Proportion of patients receiving at least one session of renal replacement therapy between inclusion and Day 14, Length of stay in the intensive care unit, Length of hospital stay, Proportion of patients receiving a dose of etoposide, Cumulative dose of etoposide over the first 14 days, within the total study population and among those receiving at least one dose of treatment, Number of days between inclusion and initiation of etoposide treatment in patients who received etoposide, Number of patients receiving another immunosuppressive treatment during the intensive care unit stay up to Day 14, Time from inclusion to normalization of fibrinogen (> 2 g/L), decrease in ferritin (< 2000 μg/L), and decrease in triglycerides (< 1.5 mg/dL) during the intensive care unit stay up to Day 14, HScore at Days 2, 7, and 14, Proportion of patients experiencing healthcare-associated infections, acquired neutropenia after inclusion (defined by ANC < 500/mm³) and its duration if applicable, and post-inclusion bleeding event requiring transfusion and/or surgical intervention, Delta SOFA at Days 2 and 5, maximum SOFA score, including both SOFA and modified SOFA

Source: https://euclinicaltrials.eu/ctis-public/view/2024-511807-41-01